EU clinical trial 2022-500085-96-00: NAlmefene versus placebo in addition to treatment as usual on craving in Behavioural Addictions (NABAb)
Protocol code: RC21_0336
Sponsor: Centre Hospitalier Universitaire De Nantes (Hospital/Clinic/Other health care facility). Phase: Therapeutic confirmatory (Phase III). Countries: France (ongoing, recruiting).
Therapeutic area(s): Psychiatry and Psychology [F] - Behavior and Behavior Mechanisms [F01]
Gender: Female, Male. Age: 18-64 years, 65+ years. Enrolment: 266.
Status: Ongoing, recruiting. Start date (EU): 2023-03-31. Decision date: 2022-08-05. Results received: No. Last updated: 2025-04-28.

Condition(s): Patients with gambling disorder or sexual addiction or food addiction
Product: Placebo for therapeutic use (capsule #3), 99,90mg of cellulose microcristaline and 0,10mg of sillice colloïde anhydre, form ARROW Génériques, Selincro 18 mg film-coated tablets

Primary endpoint: Variation of averaged intensity of craving episodes between start (during the week preceding initiation of treatment) and end (during the week preceding end of treatment) of treatment. Each craving episode will be reported by the patient on a weekly diary, with intensity assessed through a Numerical Rating Scale (NRS).
Endpoint(s): Variation of averaged weekly frequency (number of episodes) and duration (cumulative duration of all episodes) of craving episodes between start and end of treatment., Variation of averaged weekly intensity, frequency and duration of craving episodes between start of treatment and 4 weeks after the end of treatment., Variation of averaged weekly frequency, duration and intensity (assessed through a NRS) of the BA episodes: (i) between start and end of treatment and (ii) between start of treatment and 4 weeks after the end of treatment., Overall clinical improvement, assessed though the Clinical Global Impression – Improvement (CGI-I) scale and the GGI – Efficacy Index (CGI-EI)., Variation of averaged weekly use of psychoactive substances (including nicotine) and daily life behaviors of interest (gambling, sex, food) between start of treatment and 4 weeks after the end of treatment., Number, type and severity of self-reported adverse side effects, during either weeks of treatment at a dosage of 18 mg/d or 36 mg/d., Mutation(s) associated with non-response to nalmefene treatment; such mutations will be identified using a NGS (Next-Generation Sequencing) panel., Sociodemographic, medical and clinical data, especially psychiatric and addictive co-morbidities assessed with the Mini International Neuropsychiatric Interview – Simplified (MINI-S) and the age of the BA

Source: https://euclinicaltrials.eu/ctis-public/view/2022-500085-96-00